EU clinical trial 2024-513231-24-00: An Extension Study to Evaluate the Long-Term Outcomes of Patients Who Received Treatment for Retinopathy of Prematurity in the VGFTe-ROP-1920 Study
Protocol code: VGFTe-ROP-2036
Sponsor: Regeneron Pharmaceuticals Inc. (Pharmaceutical company). Phase: Therapeutic confirmatory (Phase III). Countries: Romania (ongoing, recruitment ended), Bulgaria (ongoing, recruitment ended).
Therapeutic area(s): Diseases [C] - Eye Diseases [C11]
Gender: Female, Male. Age: 0-17 years. Enrolment: 7.
Status: Ongoing, recruitment ended. Start date (EU): 2022-03-22. Decision date: 2024-10-04. Results received: No. Last updated: 2026-06-16.
Decision dates by country: RO: 2025-01-13, BG: 2025-01-13

Condition(s): Retinopathy of prematurity (ROP)
Product: Eylea 40 mg/mL solution for injection in a vial

Primary endpoint: Binocular best-corrected visual acuity (BCVA), Proportion of Patients with Adverse Events, Proportion of Patients with Serious Adverse Events
Endpoint(s): Proportion of patients developing unfavorable ocular structural outcome, BCVA in each eye, Refractive spherical equivalent in each eye, Neurodevelopmental outcomes using BSID-III, Neurodevelopmental outcomes using WPPSI-IV, Neurodevelopmental outcomes using VABS-II, Proportion of patients with recurrence of ROP, Proportion of patients requiring treatment for ROP

Source: https://euclinicaltrials.eu/ctis-public/view/2024-513231-24-00